EU clinical trial 2024-519071-25-00: An Open-label, Multicenter, Phase 1a/1b Study to Evaluate the Safety and Anti-tumor Activity of TT125-802 in Combination With Adagrasib, Osimertinib or Docetaxel in Patients with Advanced NSCLC
Protocol code: TT-CSP-101
Sponsor: TOLREMO therapeutics AG (Pharmaceutical company). Phase: Human Pharmacology (Phase I)- Other. Countries: Spain (authorised, recruitment pending).
Therapeutic area(s): Diseases [C] - Neoplasms [C04]
Gender: Female, Male. Age: 18-64 years, 65+ years. Enrolment: 40.
Status: Authorised, recruitment pending. Decision date: 2025-06-27. Results received: No. Last updated: 2026-06-01.

Condition(s): Advanced NSCLC

Source: https://euclinicaltrials.eu/ctis-public/view/2024-519071-25-00